EU clinical trial 2025-522664-32-00: An Open-Label Study to Evaluate the Pharmacokinetics, Pharmacodynamics, Efficacy, and Safety of a Single Dose of ANX005 in Participants With Guillain-Barré Syndrome
Protocol code: ANX005-GBS-05
Sponsor: Annexon Inc. (Pharmaceutical company). Phase: Therapeutic confirmatory (Phase III). Countries: Denmark (authorised, recruiting), France (authorised, recruitment pending), Spain (authorised, recruitment pending).
Therapeutic area(s): Diseases [C] - Musculoskeletal Diseases [C05]; Diseases [C] - Immune System Diseases [C20]
Gender: Female, Male. Age: 0-17 years, 18-64 years, 65+ years. Enrolment: 15.
Start date (EU): 2025-12-10. Decision date: 2025-11-11. Results received: No. Last updated: 2026-07-27.
Decision dates by country: DK: 2025-11-11, ES: 2026-04-20, FR: 2026-04-17

Condition(s): Guillain Barre Syndrome
Product: ANX005

Primary endpoint: Noncompartmental PK parameters of ANX005 in serum through Week 2
Endpoint(s): Change from Baseline in free C1q protein concentration in serum through Week 2 • Change from Baseline in percent complement pathway activity in serum through Week 2, Medical Research Council (MRC) sumscore change from Baseline at Week 1

Source: https://euclinicaltrials.eu/ctis-public/view/2025-522664-32-00